EU clinical trial 2023-507936-20-00: A Phase 3, Double-Blind, Randomized, Placebo-Controlled Trial of Quizartinib Administered in Combination with Induction and Consolidation Chemotherapy and Administered as Maintenance Therapy in Adult Patients with Newly Diagnosed FLT3-ITD Negative Acute Myeloid Leukemia (QuANTUM-Wild)
Protocol code: AC220-168
Sponsor: Daiichi Sankyo Inc. (Pharmaceutical company). Phase: Therapeutic confirmatory (Phase III). Countries: Portugal (ongoing, recruitment ended), Italy (ongoing, recruitment ended), Belgium (ongoing, recruitment ended), Spain (ongoing, recruitment ended), Bulgaria (ongoing, recruitment ended), Croatia (ongoing, recruitment ended), Hungary (ended), Poland (ended), Romania (ongoing, recruitment ended), Germany (ongoing, recruitment ended), Sweden (ongoing, recruitment ended), Norway (ongoing, recruitment ended), France (ongoing, recruitment ended), Austria (ongoing, recruitment ended), Czechia (ongoing, recruitment ended).
Therapeutic area(s): Diseases [C] - Neoplasms [C04]
Gender: Female, Male. Age: 18-64 years, 65+ years. Enrolment: 288.
Start date (EU): 2025-05-05. Decision date: 2025-03-18. Results received: No. Last updated: 2026-07-23.
Decision dates by country: HU: 2025-03-20, BE: 2025-03-18, PL: 2025-03-24, SE: 2025-04-16, RO: 2025-04-03, PT: 2025-03-21, CZ: 2025-03-18, AT: 2025-04-03, NO: 2025-03-19, BG: 2025-03-19, FR: 2025-03-19, HR: 2025-03-24, IT: 2025-03-24, DE: 2025-03-19, ES: 2025-03-19

Condition(s): Acute myeloid leukemia
Product: Quizartinib, Citarabina Hikma 100mg/5mL Soluzione Iniettabile, Daunoblastin 20 mg Pulver zur Herstellung einer Infusions- oder Injektionslösung, Matching placebo tablets without active substance, Idarubicin Ebewe 1 mg/ml Konzentrat zur Herstellung einer Infusionslösung, Quizartinib

Primary endpoint: Overall survival (OS) in participants with newly diagnosed FLT3 ITD negative AML
Endpoint(s): (Arm A vs Arm B) Event-free survival (EFS): Time from randomization to date of failure to achieve CR (as assessed by IRC) at end of induction, relapse after CR, or death due to any cause, whichever occurs first, (Arm A vs Arm B) Duration of complete response (DoCR): Time from the first documented CR until documented relapse or death due to any cause, whichever comes first, (Arm A vs Arm B) Relapse Free Survival (RFS): Time from randomization, for participants who achieve CR in the Induction Phase, until relapse or death due to any cause, whichever comes first, (Arm A vs Arm B) Complete remission rate (CR): Percentage of participants who achieved a CR, (Arm A vs Arm B) CR with minimal or measurable residual disease (MRD) negativity: MRD negativity by NPM1, CBF, and FLT3-ITD (assessed individually in patients with NPM1 and CBF mutations present at screening and in all patients for FLT3-ITD MRD levels), (Arm A vs B) Incidence of treatment-emergent adverse events (TEAEs), serious (TEAEs), AESIs, changes in vital signs, ECG, safety laboratory evaluations and physical examinations, Arm A vs Arm B) Plasma concentrations at each time point and PK parameters (AUC24h, Cmax, Cmin, Tmax, and accumulation ratio and parent/metabolite ratio), (Arm B vs C) OS: Time from randomization to date of death due to any cause

Source: https://euclinicaltrials.eu/ctis-public/view/2023-507936-20-00